EU clinical trial 2023-505153-41-00: Randomized, open-label, single dose, four-period, cross-over drug-drug interaction study comparing reference products Crestor 20 mg film coated tablets, Norvasc 10 mg tablets and Tritace 10 mg tablets administrated concomitantly versus each drug administrated alone in healthy male and female subjects under fasting conditions. Sponsor's study number: ROS-AML-RAM-DDI-03-23
Sponsor: Adamed Pharma S.A. (Pharmaceutical company). Phase: Human Pharmacology (Phase I)- Other. Countries: Czechia (ended).
Therapeutic area(s): Diseases [C] - Cardiovascular Diseases [C14]
Gender: Female, Male. Age: 18-64 years. Enrolment: 60.
Status: Ended. Start date (EU): 2023-08-17. End date (EU): 2023-12-05. Decision date: 2023-07-04. Results received: Yes. Last updated: 2023-07-17.

Condition(s): Not applicable (submitted trial is a study in healthy subjects).
Product: TRITACE 10 mg comprimate, Crestor, 20 mg, tabletki powlekane, Heparin Léčiva Injekční roztok, Norvasc, 10 mg, tabletki

Primary endpoint: AUC(0-72h) or AUC(0-t), and Cmax. 90% geometric confidence interval for the ratios (R1+R2+R3 vs R1, R1+R2+R3 vs R2, R1+R2+R3 vs R3) based on least squares means of back-transformed PK parameters will be calculated.
Endpoint(s): tmax, AUC(0-∞), AUCres, t1/2 and λz (if applicable)

Source: https://euclinicaltrials.eu/ctis-public/view/2023-505153-41-00